EU clinical trial 2024-520037-76-00: INTERACT-FAPI: “The value of 68Ga-FAPI PET/CT for evaluating peritoneal treatment response.”
Sponsor: Erasmus Universitair Medisch Centrum Rotterdam (Erasmus MC) (Hospital/Clinic/Other health care facility). Phase: Human Pharmacology (Phase I)- Other. Countries: Netherlands (ongoing, recruiting).
Therapeutic area(s): Diseases [C] - Neoplasms [C04]
Gender: Female, Male. Age: 18-64 years, 65+ years. Enrolment: 16.
Status: Ongoing, recruiting. Start date (EU): 2026-01-27. Decision date: 2025-08-18. Results received: No. Last updated: 2025-08-18.

Condition(s): Peritoneal metastases
Product: 68GA-FAPI-46

Primary endpoint: The accuracy will be calculated as the sensitivity of the ⁶⁸Ga-FAPI PET/CT with clinical assessment during MTB and/or histopathological outcome at second laparoscopy as a reference standard.
Endpoint(s): The absolute change in peritoneal tumor size or volume as measured by imaging before and after treatment.

Source: https://euclinicaltrials.eu/ctis-public/view/2024-520037-76-00